EU clinical trial 2023-506949-27-00: Identifying Individuals at Risk of Glucocorticoid-Induced Impairment of Bone Disease (RIGID)
Sponsor: Odense University Hospital (Hospital/Clinic/Other health care facility). Phase: Therapeutic exploratory (Phase II). Countries: Denmark (ended).
Therapeutic area(s): Diseases [C] - Hormonal diseases [C19]
Gender: Female, Male. Age: 18-64 years. Enrolment: 36.
Status: Ended. Start date (EU): 2024-10-14. End date (EU): 2026-03-30. Decision date: 2024-03-27. Results received: No. Last updated: 2025-12-05.

Condition(s): Secondary Osteoporosis
Product: Prednisolone 25mg Tablets, PLACEBO

Primary endpoint: Changes in the level of P1NP in peripheral blood from baseline to day 7
Endpoint(s): Changes in the level of CTX in peripheral blood from baseline to day 7 and 14, Changes in the level of P1NP in peripheral blood from baseline to day 14, Changes in GC metabolites in blood from baseline to day 7 (e.g., prednisone levels, and the prednisolone/prednisone ratio), Changes in gene expression in abdominal and gluteal subcutaneous adipose tissue from baseline to day 7 (e.g., adiponectin or visfatin), Changes in gene expression in bone tissue from baseline to day 7 (e.g., RUNX2 or osteocalcin), Changes in insulin secretion and sensitivity from baseline to day 7

Source: https://euclinicaltrials.eu/ctis-public/view/2023-506949-27-00